EU clinical trial 2024-516435-27-00: AAA-IPC 2011-003 - Prospective and multicentre evaluation of 3 different doses of IV busulfan associated with fludarabine and thymoglobuline in the conditioning of allogeneic stem cell transplantation (SCT) from a matched related or unrelated donor in patients with poor prognosis myeloïd malignancies
Sponsor: Institut Paoli Calmettes (Hospital/Clinic/Other health care facility). Phase: Therapeutic exploratory (Phase II). Countries: France (ended).
Therapeutic area(s): Diseases [C] - Neoplasms [C04]; Diseases [C] - Immune System Diseases [C20]
Gender: Female, Male. Age: 18-64 years, 65+ years. Enrolment: 177.
Status: Ended. Start date (EU): 2024-11-05. End date (EU): 2026-05-27. Decision date: 2024-11-05. Results received: No. Last updated: 2024-11-05.

Condition(s): High-risk myeloïd malignancies
Product: Busulfan 6 mg/ml concentrate for solution for infusion, THYMOGLOBULINE 5 mg/ml, poudre pour solution pour perfusion, Fludarabine Accord Healthcare 25 mg/ml solution à diluer pour solution injectable /pour perfusion

Primary endpoint: Time to progression or death
Endpoint(s): Time to death and cause of death, Time to acute and chronic GVHD according to the NIH classification and relapse, Response to treatment, Hematological recovery defined as the achievement 500 ANC and 50 000 platelets (without transfusion), Full donor chimerism achievement at M1, M2, M3, Occurrence of grade 3-4 adverse events according the CTC AE v4.0 scale within 6 months after conditionning

Source: https://euclinicaltrials.eu/ctis-public/view/2024-516435-27-00